EU clinical trial 2025-521563-13-01: Safety and efficacy of T10430 eye drops in controlling paediatric myopia progression
Protocol code: LT10430-201
Sponsor: Laboratoires Thea (Pharmaceutical company). Phase: Therapeutic exploratory (Phase II). Countries: Ireland (ongoing, recruiting).
Therapeutic area(s): Diseases [C] - Eye Diseases [C11]
Gender: Female, Male. Age: 0-17 years. Enrolment: 20.
Status: Ongoing, recruiting. Start date (EU): 2026-06-30. Decision date: 2026-05-22. Results received: No. Last updated: 2026-05-22.

Condition(s): Paediatric myopia
Product: Preservative-free, ophthalmic solution

Primary endpoint: Frequency of ocular treatment-emergent adverse events (TEAEs), serious ocular TEAEs, IMP-related ocular TEAEs, ocular TEAEs leading to premature IMP discontinuation by system organ class (SOC) and preferred term (PT).
Endpoint(s): Change from baseline in Axial Length AL (mm) at 6 months and 12 months in both eyes., Change from baseline in cycloplegic spherical equivalent refractive error (SER) (D) at 6 months and 12 months in both eyes., Change from baseline in distant and near best-corrected visual acuity (BCVA at 1 month, 6 months, and 12 months in LogMAR in both eyes, Score and change from baseline in conjunctival hyperemia at 1 month, 6 months, and 12 months in both eyes., Score and change from baseline in corneal fluorescein staining (CFS) at 1 month, 6 months, and 12 months in both eyes., Score and change from baseline in conjunctival fluorescein staining at 1 month, 6 months, and 12 months in both eyes., Change from baseline in TBUT (s) at 1 month, 6 months, and 12 months in both eyes., Change from baseline in IOP (mmHg) at 1 month, 6 months, and 12 months in both eyes., Change from baseline in central corneal thickness (µm) and in thinnest corneal thickness (µm) at 1 month, 6 months and 12 months in both eyes., Change from baseline in Biometry keratometry anterior chamber depth (ACD) (mm), lens thickness (LT) (mm), K1, K2 and Kmax in D, at 6 months and 12 months in both eyes., Change and relative change from baseline in central corneal endothelial cells (CEC) density (cell/mm2) at 1 month, 6 months and 12 months in both eyes., Hexagonality ratio of CEC (%) at 1 month, 6 months and 12 months in both eyes., Change from baseline in coefficient of variation (CV) of CEC size at 1 month, 6 months and 12 months in both eyes., Score of each ocular symptom throughout the day, total score of ocular symptoms and change from baseline in total score at all visits and phone calls., Score of each ocular symptom immediately after instillation and total score at all post-baseline visits and phone calls., Frequency of systemic TEAEs, serious systemic TEAEs, IMP-related systemic TEAEs, systemic TEAEs leading to premature IMP discontinuation by SOC and PT., Ocular tolerance assessed by the investigator at 1 month, 6 months and 12 months., Ocular tolerance assessed by the participant/relatives at all post-baseline visits and phone calls., Global satisfaction with the use of the single dose container assessed by the participant/legal guardian(s) at all post-baseline visits and phone calls.

Source: https://euclinicaltrials.eu/ctis-public/view/2025-521563-13-01